EU clinical trial 2025-520887-17-00: Dexamethasone for the treatment of traumatic brain injured patients with brain contusions and pericontusional edema: Study protocol for a prospective, randomized and double blind trial
Sponsor: University Hospital Son Espases (Hospital/Clinic/Other health care facility). Phase: Therapeutic use (Phase IV). Countries: Spain (authorised, recruitment pending).
Therapeutic area(s): Diseases [C] - Nervous System Diseases [C10]
Gender: Female, Male. Age: 18-64 years, 65+ years. Enrolment: 1.
Status: Authorised, recruitment pending. Decision date: 2026-03-26. Results received: No. Last updated: 2026-03-26.

Condition(s): Post-traumatic brain contusion with edema
Product: 10 g Celulosa microcristalina 250 g Acofarma; CL 0,1 g Riboflavina (vit. B2) (vit. B2) 250 g Acofarma 200 cáps Cápsulas Nº4 blancas-verdes 1000 Ud Acofarma, Fortecortin 4 mg tablety

Primary endpoint: To evaluate the efficacy of treatment with dexamethasone compared to placebo, measured by the proportion of patients who, one month after the trauma, present good evolution according to the “Extended Glasgow Outcome Scale (GOSE)”.

Source: https://euclinicaltrials.eu/ctis-public/view/2025-520887-17-00